EU clinical trial 2025-521836-12-00: Colchicine to Quench the Inflammatory Response after Deep Vein Thrombosis: The CONQUER-DVT Randomized Controlled Trial
Sponsor: Universita' Degli Studi G. D'Annunzio Di Chieti (Educational Institution). Phase: Therapeutic exploratory (Phase II). Countries: Italy (authorised, recruitment pending).
Therapeutic area(s): Diseases [C] - Hemic and Lymphatic Diseases [C15]
Gender: Female, Male. Age: 18-64 years, 65+ years. Enrolment: 122.
Status: Authorised, recruitment pending. Decision date: 2026-04-23. Results received: No. Last updated: 2026-06-08.

Condition(s): deep vein thrombosis
Product: COLCHICINA LIRCA 0.5 mg compresse, Placebo Colchicine Tablets: lactose, extra-fine sugar, spray-dried acacia, and, magnesium stearate

Primary endpoint: PTS (Villalta score ≥5) at 12 months
Endpoint(s): Proportion of patients with PTS (Villalta score ≥5) at 6 months, Proportion of patients according to the following PTS severity categories based on Villalta score category: mild (Villalta Score 5-9), moderate (Villalta score 10-14), severe (Villalta score ≥15 or presence of ulcer) at 6 and 12 months, Mean Villalta score and mean change from baseline (based on continuous Villalta score) at 6 and 12 months to estimate the severity of PTS, Incidence rate of recurrent venous thromboembolism (VTE) during follow-up (up to 12 months), Incidence rate of arterial thromboembolism (ATE) during follow-up (up to 12 months), Incidence rate of composite of adverse vascular events (comprising PTS, recurrent VTE, ATE) during follow-up (up to 12 months), Incidence rate of major bleeding (as per International Society of Thrombosis and Haemostasis (ISTH) definition) during follow-up (up to 12 months), Incidence rate of clinically relevant non-major bleeding (as per ISTH definition) during follow-up (up to 12 months), All-cause mortality rate, Mean changes in patient-reported outcome measures (PROMs) from baseline to 6 and 12 months as assessed by functional scales (Patient reported Villalta-scale - PRV, Post-venous thromboembolism functional status - PVFS), and generic health-related and disease specific QOL questionnaires (EuroQoL-EQ-5D-5L, VEINES QOL/Sym, PEmb-QoL), Safety endpoints: 1.Number and incidence rate of gastrointestinal adverse events that result in study drug discontinuation 2.Number and incidence rate of muscle pain episodes that results in study drug discontinuation 3.Number and incidence rate of infections episodes leading to hospitalization. Other: renal insufficiency; neutropenia and/or neuropathy leading to study drug discontinuatio

Source: https://euclinicaltrials.eu/ctis-public/view/2025-521836-12-00